EU clinical trial 2022-500265-27-00: Analgesic effectiveness of capsaicin 8% cutaneous patch for the treatment of chronic postsurgical or post-traumatic neuropathic pain: a randomized placebo controlled study in children aged 12 to 17-y
Protocol code: 29BRC21.0184
Sponsor: Centre Hospitalier Regional Et Universitaire De Brest (Hospital/Clinic/Other health care facility). Phase: Therapeutic confirmatory (Phase III). Countries: France (ongoing, recruiting).
Therapeutic area(s): Diseases [C] - Nervous System Diseases [C10]
Gender: Female, Male. Age: 0-17 years. Enrolment: 46.
Status: Ongoing, recruiting. Start date (EU): 2024-03-05. Decision date: 2023-07-31. Results received: No. Last updated: 2026-07-21.

Condition(s): Chronic postchirurgical or post-traumatic neuropathic pain
Product: Qutenza 179 mg cutaneous patch, Tramadol 100 mg/ml oral drops, solution, Comfeel plus transparent (hydrocolloid dressing): a medical device classe iib. Details are specified in the protocol and the cover letter (2nd pragraph). a ticket is open in the desk service (sd-729570)

Primary endpoint: Difference in Neuropathic Pain Symptom Inventory score evaluated between the first application (M0) of capsaicin or placebo and 4 months later (M4).
Endpoint(s): Adverse event monitoring are collected during patch application and by phone calls in the following days., Vital signs including cardiac frequency and arteriel pressure., Physical examination including dermal assessment, Intake of rescue medication against pain (YES/NO), Duration of patch application, Global score and subscores of NPSI (Neuropathic Pain Syndrome Inventory) questionnaire without support, score from 0 to 100, higher score is worse outcome, Global score of FDI (Functional Disability Inventory) questionnaire, score from 0 to 60, higher score is worse outcome

Source: https://euclinicaltrials.eu/ctis-public/view/2022-500265-27-00